EU clinical trial 2023-506211-18-00: PROPOSE: Effect of Intravaginal Prasterone on Genitourinary Syndrome in Women in Menopause with previous Breast Cancer or currently under treatment with endocrine therapy for Breast Cancer with aromatase inhibitor +/- LHRHa
Sponsor: Istituto Europeo Di Oncologia S.r.l. (Hospital/Clinic/Other health care facility). Phase: Therapeutic confirmatory (Phase III). Countries: Italy (ongoing, recruiting).
Therapeutic area(s): Phenomena and Processes [G] - Reproductive and Urinary Physiological Phenomena [G08]; Diseases [C] - Hormonal diseases [C19]; Health Care [N] - Health Care Quality, Access, and Evaluation [N05]; Diseases [C] - Neoplasms [C04]; Diseases [C] - Female Urogenital Diseases and Pregnancy Complications [C13]; Diseases [C] - Skin and Connective Tissue Diseases [C17]
Gender: Female. Age: 18-64 years, 65+ years. Enrolment: 95.
Status: Ongoing, recruiting. Start date (EU): 2025-01-09. Decision date: 2024-07-26. Results received: No. Last updated: 2026-05-14.
Decision dates by country: IT: 2024-08-26

Condition(s): Postmenopausal women with previous breast cancer or currently under anti-oesterogenic therapy (aromatase inhibitor +/- LHRH analogue) presenting vulvar, vaginal or urinary bothersome symptoms (genitourinary syndrome).
Product: Intrarosa 6.5 mg pessary

Primary endpoint: Establish the subjective improvement of genitourinary symptoms in breast cancer women at intervals defined by the study
Endpoint(s): To define the role of genito-urinary syndrome on quality of life, in particular on sexual function and mood wellbeing, in women with breast cancer before, during and after the treatment, Establish an improvement in tissue trophism throught gynecological evaluation, use of validated scales (Vaginal Health Index) and determination of the maturation index on vaginal cytology, Measurement of serum estradiol at set intervals before, during and after treatment

Source: https://euclinicaltrials.eu/ctis-public/view/2023-506211-18-00